EU clinical trial 2023-503326-39-00: First-line immunotherapy-based standard of care and local ablative treatments for oligometastatic non-small cell lung cancer patients: a randomized, multicentre, open-label phase III study (OliGRAIL)
Protocol code: CSET N° 2023/3729
Sponsor: Institut Gustave Roussy (Hospital/Clinic/Other health care facility). Phase: Therapeutic confirmatory (Phase III). Countries: France (ongoing, recruiting).
Therapeutic area(s): Diseases [C] - Immune System Diseases [C20]; Diseases [C] - Respiratory Tract Diseases [C08]
Gender: Female, Male. Age: 18-64 years, 65+ years. Enrolment: 130.
Status: Ongoing, recruiting. Start date (EU): 2025-03-06. Decision date: 2024-11-19. Results received: No. Last updated: 2026-04-09.

Condition(s): Synchronous oligometastatic non-small cell lung cancer (NSCLC)
Product: IMJUDO 20 mg/ml concentrate for solution for infusion., PACLITAXEL SANDOZ 6 mg/ml, solution à diluer pour perfusion, Pemetrexed Accord 25 mg/ml concentrate for solution for infusion, CARBOPLATINE KABI 10 mg/ml, solution à diluer pour perfusion, IMFINZI 50 mg/mL concentrate for solution for infusion, Tecentriq 840 mg concentrate for solution for infusion, YERVOY 5 mg/ml concentrate for solution for infusion, OPDIVO 10 mg/mL concentrate for solution for infusion., Cisplatine Accord 1 mg/ml concentraat voor oplossing voor infusie, LIBTAYO 350 mg concentrate for solution for infusion., KEYTRUDA 25 mg/mL concentrate for solution for infusion

Primary endpoint: The primary endpoint is overall survival (OS).
Endpoint(s): PFS or iPFS according to RECIST 1.1 and iRECIST., Cancer specific survival., Type of relapses, local and distant control rates in both arms., Acute/ late adverse events graded by CTCAE v5 (toxic death and serious adverse events)., QoL according to EORTC QLQ-C30, QLQ-LC-13, EQ-5D-5L, Clearance rate at 6 weeks and 4 months (before maintenance) of circulating tumour DNA assessed in plasma compared to value at baseline in the 2 arms., Economic evaluation: incremental cost per Quality-adjusted life year (QALY based on EQ-5D-5L measures), incremental net monetary benefit., Effect of RLT modality (minimally invasive surgery vs stereotactic body radiation therapy (SBRT) vs interventional radiology) on OS and local control., Impact of metastatic site (e.g., brain-only vs. others) on OS and local control.

Source: https://euclinicaltrials.eu/ctis-public/view/2023-503326-39-00